EU clinical trial 2025-524090-16-00: A Phase 1/2 Study of BMS-986525 as Monotherapy and in Combination with Nivolumab in Participants with Relapsed/Refractory Small Cell Lung Cancer
Protocol code: CA258-0001
Sponsor: Bristol-Myers Squibb Services Unlimited Company (Pharmaceutical company). Phase: Phase I and Phase II (Integrated)- First administration to humans. Countries: Italy (authorised, recruiting), Spain (ongoing, recruiting), Romania (authorised, recruiting).
Therapeutic area(s): Diseases [C] - Neoplasms [C04]
Gender: Female, Male. Age: 18-64 years, 65+ years. Enrolment: 21.
Start date (EU): 2026-06-24. Decision date: 2026-05-18. Results received: No. Last updated: 2026-05-25.
Decision dates by country: IT: 2026-05-18, RO: 2026-05-25, ES: 2026-05-22

Condition(s): Relapsed/Refractory Small Cell Lung Cancer
Product: BMS-986525, OPDIVO 10 mg/mL concentrate for solution for infusion.

Primary endpoint: Type, frequency, and severity of side effects.
Endpoint(s): How BMS-986525 behaves in the body alone and in combination with nivolumab;, How disease responds to BMS-986525 alone or in combination with nivolumab.

Source: https://euclinicaltrials.eu/ctis-public/view/2025-524090-16-00